EU clinical trial 2024-518288-37-00: Dose Escalation Study with Bispecific Antibodies in Adult Patients with Lupus Nephritis
Protocol code: R5459-1979-LN-2459
Sponsor: Regeneron Pharmaceuticals Inc. (Pharmaceutical company). Phase: Human Pharmacology (Phase I)- Other. Countries: Spain (authorised, recruitment pending), France (authorised, recruitment pending), Germany (ongoing, recruiting).
Therapeutic area(s): Diseases [C] - Immune System Diseases [C20]
Gender: Female, Male. Age: 18-64 years. Enrolment: 19.
Start date (EU): 2025-12-18. Decision date: 2025-10-07. Results received: No. Last updated: 2026-05-04.
Decision dates by country: DE: 2025-10-08, FR: 2025-10-07, ES: 2025-10-08

Condition(s): Lupus Nephritis

Source: https://euclinicaltrials.eu/ctis-public/view/2024-518288-37-00